EU clinical trial 2024-514894-22-01: Nasal application of Staphylococcus lugdunensis for decolonization of Staphylococcus aureus – a first-in-human proof-of-concept microbiome intervention study
Protocol code: LuCa UKT01
Sponsor: Universitaetsklinikum Tuebingen AöR (Hospital/Clinic/Other health care facility). Phase: Human Pharmacology (Phase I)- First administration to humans. Countries: Germany (authorised, recruitment pending).
Therapeutic area(s): Diseases [C] - Bacterial Infections and Mycoses [C01]
Gender: Female, Male. Age: 18-64 years. Enrolment: 36.
Status: Authorised, recruitment pending. Decision date: 2026-07-08. Results received: No. Last updated: 2026-07-08.

Condition(s): Persistent or intermitting colonization of the nose with Staphylococcus aureus

Source: https://euclinicaltrials.eu/ctis-public/view/2024-514894-22-01